EU clinical trial 2026-525817-29-00: A Phase 2a Study of SUN-627 to Evaluate Safety, Tolerability, Pharmacokinetics, Pharmacodynamics, and Impact on Measures of Neuroinflammation in the Central Nervous System in Participants With Non-Active Progressive Multiple Sclerosis (SPMS/PPMS)
Protocol code: SUN-627-MS201
Sponsor: Sundance Biosciences Inc. (Pharmaceutical company). Phase: Therapeutic exploratory (Phase II). Countries: Finland (authorised, recruitment pending).
Therapeutic area(s): Diseases [C] - Nervous System Diseases [C10]; Diseases [C] - Immune System Diseases [C20]
Gender: Female, Male. Age: 18-64 years, 65+ years. Enrolment: 30.
Status: Authorised, recruitment pending. Decision date: 2026-06-05. Results received: No. Last updated: 2026-06-18.

Condition(s): Multiple Sclerosis; Primary Progressive Multiple Sclerosis; non-active Secondary Progressive Multiple Sclerosis
Product: SUN-627, SUN-627, SUN-627

Primary endpoint: Incidence of treatment-emergent adverse events (TEAEs) and serious adverse events (SAEs) Time Frame: From enrollment to the end of study at 16 weeks
Endpoint(s): Markers of disease in blood and brain fluid as well as imaging to measure inflammation Time Frame: from enrollment to the end of treatment at 12 weeks

Source: https://euclinicaltrials.eu/ctis-public/view/2026-525817-29-00